EU clinical trial 2022-502962-26-00: A RANDOMIZED PROSPECTIVE CLINICAL TRIAL TO ASSESS PROCALCITONIN-GUIDANCE AND MOLECULAR-GUIDED DIAGNOSIS AS MAINSTAY FOR THERAPY OF SEVERE INFECTIONS (The MODIFY trial)
Protocol code: MODIFY
Sponsor: Hellenic Institute For The Study Of Sepsis (Laboratory/Research/Testing facility). Phase: Therapeutic confirmatory (Phase III). Countries: Greece (ongoing, recruitment ended).
Therapeutic area(s): Diseases [C] - Bacterial Infections and Mycoses [C01]
Gender: Female, Male. Age: 18-64 years, 65+ years. Enrolment: 190.
Status: Ongoing, recruitment ended. Start date (EU): 2023-09-14. Decision date: 2023-04-27. Results received: No. Last updated: 2026-07-09.

Condition(s): Severe infections
Product: CEFTOLOZANE, CEFTRIAXONE, PIPERACILLIN, CEFTOLOZANE, LINEZOLID, TEICOPLANIN, MEROPENEM, TEICOPLANIN, VABORBACTAM, TAZOBACTAM, RELEBACTAM, COLISTIMETHATE SODIUM, TAZOBACTAM, PIPERACILLIN, VANCOMYCIN, CEFUROXIME, MEROPENEM, AVIBACTAM, COLISTIMETHATE SODIUM, ANIDULAFUNGIN, CEFUROXIME, IMIPENEM, ANIDULAFUNGIN, IMIPENEM, VABORBACTAM, AVIBACTAM, VANCOMYCIN, CEFTAZIDIME, CEFTAZIDIME, MICAFUNGIN, RELEBACTAM, CEFTRIAXONE, LINEZOLID, MICAFUNGIN

Primary endpoint: The number of days under treatment with broad-spectrum antibiotics in the group receiving the MODIFY strategy compared to patients treated by standard of care.
Endpoint(s): Time to first change of antibiotics, Time to the first sterile blood culture, Maintenance of the same antimicrobial(s) in case of activity against the pathogen, At least 2-point decrease of baseline SOFA score by day 7, 28-day mortality, 90-day mortality, Incidence of laboratory documented Clostrioides difficile infection, Length of hospital stay, Cost of hospitalization, Time to escalation of antibiotics, Time to de-escalation of antibiotics

Source: https://euclinicaltrials.eu/ctis-public/view/2022-502962-26-00